EU clinical trial 2023-506929-11-00: Efficacy and safety of cagrilintide s.c. in combination with semaglutide s.c. (CagriSema s.c.) once-weekly in participants with overweight or obesity
Protocol code: NN9838-4608
Sponsor: Novo Nordisk A/S (Pharmaceutical company). Phase: Therapeutic confirmatory (Phase III). Countries: Spain (ongoing, recruitment ended), Finland (ongoing, recruitment ended), Belgium (ongoing, recruitment ended), Germany (ongoing, recruitment ended), Italy (ongoing, recruitment ended), France (ongoing, recruitment ended), Denmark (ongoing, recruitment ended), Poland (ongoing, recruitment ended), Netherlands (ongoing, recruitment ended), Bulgaria (ongoing, recruitment ended).
Therapeutic area(s): Diseases [C] - Nutritional and Metabolic Diseases [C18]
Gender: Female, Male. Age: 18-64 years, 65+ years. Enrolment: 1101.
Status: Ongoing, recruitment ended. Start date (EU): 2022-10-17. Decision date: 2024-05-22. Results received: No. Last updated: 2026-07-08.
Decision dates by country: BE: 2024-05-27, PL: 2024-05-24, DE: 2024-05-23, ES: 2024-05-24, FI: 2024-05-24, NL: 2024-05-22, FR: 2024-05-23, IT: 2024-06-03, DK: 2024-05-22, BG: 2024-06-26

Condition(s): Overweight and obesity

Primary endpoint: Relative change in body weight, Achievement of ≥ 5% weight reduction
Endpoint(s): Achievement of ≥ 20% weight reduction, Achievement of ≥ 25% weight reduction, Achievement of ≥ 30% weight reduction, Relative change in body weight, Change in waist circumference, Change in systolic blood pressure (SBP), Change in Impact of Weight on Quality Of Life-Lite Clinical Trials Version (IWQOL-Lite-CT) Physical Function score, Change in SF-36 V2 Health Survey Acute (SF-36v2) Physical Functioning score, Number of Treatment-emergent Adverse Events (TEAEs), Number of Treatment-emergent Serious adverse events (TESAEs)

Source: https://euclinicaltrials.eu/ctis-public/view/2023-506929-11-00